EU clinical trial 2024-517196-20-00: Effectiveness and cost-effectiveness of ozone treatment in patients with paresthesia (numbness, tingling) secondary to chemotherapy-induced peripheral neuropathy. Randomized, triple-blind clinical trial (OzoParQT).
Protocol code: OzoParQT
Sponsor: El Hospital Universitario De Gran Canaria Dr. Negrin (Hospital/Clinic/Other health care facility). Phase: Phase II and Phase III (Integrated). Countries: Spain (ongoing, recruiting).
Therapeutic area(s): Diseases [C] - Neoplasms [C04]; Analytical, Diagnostic and Therapeutic Techniques and Equipment [E] - Therapeutics [E02]; Diseases [C] - Nervous System Diseases [C10]
Gender: Female, Male. Age: 18-64 years, 65+ years. Enrolment: 42.
Status: Ongoing, recruiting. Start date (EU): 2025-02-07. Decision date: 2024-11-20. Results received: No. Last updated: 2024-11-20.

Condition(s): Paresthesia (numbness, tingling) secondary to chemotherapy-induced neuropathy.
Product: Oxígeno Medicinal Gas Carburos Metálicos, 99.5% v/v gas comprimido medicinal, Oxygen (by rectal insufflation)

Primary endpoint: Change from Baseline in “paresthesia” (numbness, tingling) self perceived by patients (at the end of follow-up). Self-reported evaluation of the percentage in “Numbness" and/or “Tingling” regarding the basal level. From 100% (basal level, 0% improvement) to 0% (no numbness or tingling, 100% improvement). [Time Frame: 28 weeks], Change from Baseline in quality of life by the EQ-5D-5L questionnaire (from EuroQol), (at the end of follow-up) Self-reported evaluation of: a) 5 physical and emotional items scored in five levels, from 1 (best: I have no problem) to 5 (worst: I have extreme problem or I am unable to…) and b) additional self-assessment of health by a visual analogue scale (0 = worst health patient can imagine, 100 = best health patient can imagine) [Time Frame: 28 weeks]
Endpoint(s): Direct Hospital Cost The direct expenses incurred by the hospital in providing services (medication, tests, medical visits...) during the 28 weeks of the study (in euros). [Time Frame: 28 weeks]., Change from Baseline in “paresthesia” (numbness, tingling) self-perceived by patients (at the end of ozone treatment). Self-reported evaluation of the percentage in “Numbness" and/or “Tingling” regarding the basal level. From 100% (basal level, 0% improvement) to 0% (no numbness or tingling, 100% improvement). [Time Frame: 16 weeks], Changes from Baseline in the grade of toxicity of paresthesias (numbness, tingling) according to the CTCAE v.5.0 scale (from the National Cancer Institute of EEUU). (at the end of ozone treatment). Range from: Grade 0 (asymptomatic or mild symptoms) to Grade 3 (severe symptoms, limiting self-care activities daily life) [Time Frame: 16 weeks], Changes from Baseline in the grade of toxicity of sensory neuropathy according to the CTCAE v.5.0 scale (from the National Cancer Institute of EEUU). (at the end of ozone treatment). Range from: Grade 0 (asymptomatic or mild symptoms) to Grade 4 (life-threatening consequences; urgent intervention indicated) [Time Frame: 16 weeks], Changes from Baseline in the degree of neuropathy according to the QLQ-CIPN20 scale (from the European Organization for Research & Treatment in Cancer (EORTC)). (at the end of ozone treatment). It is evaluated through 20 items that are grouped into 3 dimensions: sensitive, motor and autonomic. Range: each item is scored from 1 (nothing) to 4 (a lot). The total score for each dimension is transformed into a scale from 0 to 100, being 0 the best state and 100 the worst. [Time Frame: 16 weeks], Change from Baseline in quality of life by the EQ-5D-5L questionnaire (from EuroQol), (at the end of ozone treatment) Self-reported evaluation of: a) 5 physical and emotional items scored in five levels, from 1 (best: I have no problem) to 5 (worst: I have extreme problem or I am unable to…) and b) additional self-assessment of health by a visual analogue scale (0 = worst health patient can imagine, 100 = best health patient can imagine) [Time Frame: 16 weeks], Change from Baseline in quality of life by the QLQ-C30 questionnaire (EORTC), (at the end of ozone treatment) Self-reported evaluation of 30 items that measure several scales and symptoms. Range (after standardization): from 0 (worst for overall health and function, best for symptoms) to 100 (best for overall health and function, worst for symptoms). Time Frame: 16 weeks], Change from Baseline in Levels of anxiety and depression according to the “HAD scale” (at the end of ozone treatment) HAD scale is a self-administered questionnaire which assesses 14 items/symptoms of anxiety (7) and depression (7) experienced by patients. Each item is scored from 0 (better, no alteration) to 3 (worse level of alteration). For each symptom, overall score is from 0 (better, no anxiety or depression) to 21 (worse, very severe anxiety or depression). [Time Frame: 16 weeks], Changes from Baseline in biochemical parameters of oxidative stress (at the end of ozone treatment). Serum levels of biochemical parameters of oxidative stress. (at the end of ozone treatment). [Time Frame: 16 weeks], Changes from Baseline in biochemical parameters of inflammation (if systemic ozone therapy) (at the end of ozone treatment). Serum levels of pro-inflammatory cytokines [Time Frame: 16 weeks], Change from Baseline in Hyperspectral Image (HSI) of hands and feet (at the end of ozone treatment) Assessment of the percentage of reflectance for each wavelength [Time Frame: 16 weeks], Changes from Baseline in the grade of toxicity of paresthesias (numbness, tingling) according to the CTCAE v.5.0 scale (from the National Cancer Institute of EEUU). (at the end of follow-up). Range from: Grade 0 (asymptomatic or mild symptoms) to Grade 3 (severe symptoms, limiting self-care activities daily life) [Time Frame: 28 weeks], Changes from Baseline in the grade of toxicity of sensory neuropathy according to the CTCAE v.5.0 scale (from the National Cancer Institute of EEUU). (at the end of follow-up). Range from: Grade 0 (asymptomatic or mild symptoms) to Grade 4 (life-threatening consequences; urgent intervention indicated) [Time Frame: 28 weeks], Changes from Baseline in the degree of neuropathy according to the QLQ-CIPN20 scale (from the European Organization for Research & Treatment in Cancer (EORTC)). (at the end of follow-up). It is evaluated through 20 items that are grouped into 3 dimensions: sensitive, motor and autonomic. Range: each item is scored from 1 (nothing) to 4 (a lot). The total score for each dimension is transformed into a scale from 0 to 100, being 0 the best state and 100 the worst. [Time Frame: 28 weeks], Change from Baseline in quality of life by the QLQ-C30 questionnaire (EORTC), (at the end of follow-up) Self-reported evaluation of 30 items that measure several scales and symptoms. Range (after standardization): from 0 (worst for overall health and function, best for symptoms) to 100 (best for overall health and function, worst for symptoms). Time Frame: 28 weeks], Change from Baseline in Levels of anxiety and depression according to the “HAD scale” (at the end of follow-up) HAD scale is a self-administered questionnaire which assesses 14 items/symptoms of anxiety (7) and depression (7) experienced by patients. Each item is scored from 0 (better, no alteration) to 3 (worse level of alteration). For each symptom, overall score is from 0 (better, no anxiety or depression) to 21 (worse, very severe anxiety or depression). [Time Frame: 28 weeks], Changes from Baseline in biochemical parameters of oxidative stress (at the end of ozone treatment). Serum levels of biochemical parameters of oxidative stress. (at the end of follow-up). [Time Frame: 28 weeks], Changes from Baseline in biochemical parameters of inflammation (if systemic ozone therapy) (at the end of follow-up). Serum levels of pro-inflammatory cytokines [Time Frame: 28 weeks], Change from Baseline in Hyperspectral Image (HIS) of hands and feet (at the end of follow-up) Assessment of the percentage of reflectance for each wavelength [Time Frame: 28 weeks], Toxicity of rectal ozone therapy in these patients. at the end of follow-up. [Time Frame: 28 weeks]

Source: https://euclinicaltrials.eu/ctis-public/view/2024-517196-20-00